EU clinical trial 2025-521278-32-00: A Phase 2 Randomized, Double-blind, Placebo-Controlled Study of the Safety and Efficacy of MTX-463 in Participants with Idiopathic Pulmonary Fibrosis (IPF)
Protocol code: MTX-463-I201
Sponsor: Mediar Therapeutics Inc. (Pharmaceutical company). Phase: Therapeutic exploratory (Phase II). Countries: Croatia (authorised, recruiting), Ireland (ongoing, recruiting), Netherlands (ongoing, recruiting), Spain (ongoing, recruiting), France (ongoing, recruiting), Belgium (ongoing, recruiting).
Therapeutic area(s): Diseases [C] - Immune System Diseases [C20]
Gender: Female, Male. Age: 18-64 years, 65+ years. Enrolment: 58.
Start date (EU): 2025-12-04. Decision date: 2025-10-01. Results received: No. Last updated: 2026-06-15.
Decision dates by country: FR: 2025-10-06, HR: 2025-10-06, ES: 2025-11-14, IE: 2025-10-03, NL: 2025-10-02, BE: 2025-10-29

Condition(s): Idiopathic Pulmonary Fibrosis (IPF)
Product: NaCl 0,9 % B. Braun, solution pour perfusion, DEXTROSE/VIOSER 5% w/v Solution for Infusion

Primary endpoint: Change from Baseline to Week 24 in FVC
Endpoint(s): Incidence, seriousness, and severity of treatment-emergent adverse events (TEAEs) and treatment-related adverse events (TRAEs); and incidence of dose interruptions and discontinuations • Clinically significant findings on physical examinations, vital signs, and clinical laboratory tests, Change from Baseline to Week 24 in the FVCpp, Sparse PK profiles will be evaluated by population PK analyses

Source: https://euclinicaltrials.eu/ctis-public/view/2025-521278-32-00